EU clinical trial 2023-504491-15-00: This study will evaluate the safety, tolerability, and pharmacokinetics of Runimotamab administered intravenously as a single agent and in combination with Trastuzumab in participants with locally advanced or metastatic Human Epidermal Growth Factor Receptor 2 (HER2)-expressing cancers
Protocol code: GO40311
Sponsor: Genentech Inc. (Pharmaceutical company). Phase: Human Pharmacology (Phase I)- First administration to humans. Countries: Spain (ended), Belgium (ended), Denmark (ended), Italy (ongoing, recruitment ended), France (ongoing, recruitment ended), Netherlands (ended).
Therapeutic area(s): Diseases [C] - Neoplasms [C04]; Health Care [N] - Environment and Public Health [N06]
Gender: Female, Male. Age: 18-64 years, 65+ years. Enrolment: 187.
Start date (EU): 2020-10-30. Decision date: 2023-10-10. Results received: No. Last updated: 2026-07-09.
Decision dates by country: NL: 2023-11-14, ES: 2023-10-10, DK: 2023-10-11, IT: 2023-10-25, BE: 2023-10-12, FR: 2023-11-08

Condition(s): Human epidermal growth factor receptor (HER2)-Expressing Cancers

Source: https://euclinicaltrials.eu/ctis-public/view/2023-504491-15-00